EU clinical trial 2024-515621-28-00: A study to investigate the bioavailability of the SAR444656 test formulation and the food effect on the SAR444656 test formulation in healthy adult participants
Protocol code: BDR17530
Sponsor: Sanofi-Aventis Recherche & Developpement (Pharmaceutical company). Phase: Human Pharmacology (Phase I)- Other. Countries: Belgium (ended).
Therapeutic area(s): Diseases [C] - Immune System Diseases [C20]
Gender: Female, Male. Age: 18-64 years. Enrolment: 80.
Status: Ended. Start date (EU): 2025-04-17. End date (EU): 2025-06-24. Decision date: 2025-03-25. Results received: No. Last updated: 2025-06-30.

Condition(s): Healthy Volunteer

Source: https://euclinicaltrials.eu/ctis-public/view/2024-515621-28-00